EU clinical trial 2024-516199-14-00: A Long-Term Extension Study to Evaluate the Safety of Filgotinib in Subjects with Ulcerative Colitis
Protocol code: GS-US-418-3899
Sponsor: Alfasigma S.p.A. (Pharmaceutical company). Phase: Therapeutic confirmatory (Phase III). Countries: Hungary (ongoing, recruitment ended).
Therapeutic area(s): Diseases [C] - Digestive System Diseases [C06]
Gender: Female, Male. Age: 18-64 years, 65+ years. Enrolment: 26.
Status: Ongoing, recruitment ended. Start date (EU): 2017-04-12. Decision date: 2024-09-03. Results received: No. Last updated: 2026-03-31.

Condition(s): Ulcerative Colitis (UC)
Product: Jyseleca 100 mg film-coated tablets, Jyseleca 200 mg film-coated tablets, Composition apart from the active substance otherwise to identical to IMP

Primary endpoint: Safety, evaluated through AEs, clinical laboratory tests, and vital signs
Endpoint(s): To evaluate the effect of filgotinib on partial Mayo Clinic Score (MCS)

Source: https://euclinicaltrials.eu/ctis-public/view/2024-516199-14-00